EU clinical trial 2024-518704-41-00: Efficacy of Polatuzumab, Bendamustine and Rituximab in patients with relapsed/refractory mantle cell lymphoma- A single center phase II trial
Protocol code: Pola_R_Benda
Sponsor: Medical University Of Vienna (Educational Institution). Phase: Therapeutic exploratory (Phase II). Countries: Austria (ended).
Therapeutic area(s): Diseases [C] - Neoplasms [C04]
Gender: Female, Male. Age: 18-64 years, 65+ years. Enrolment: 16.
Status: Ended. Start date (EU): 2023-07-12. End date (EU): 2025-06-17. Decision date: 2024-12-10. Results received: Yes. Last updated: 2024-12-10.

Condition(s): Mantle cell lymphoma
Product: MabThera 500 mg concentrate for solution for infusion, Polivy 30 mg powder for concentrate for solution for infusion., Bendamustin Accord 2,5 mg/ml Pulver für ein Konzentrat zur Herstellung einer Infusionslösung

Primary endpoint: Safety, response assessment and duration

Source: https://euclinicaltrials.eu/ctis-public/view/2024-518704-41-00